EU clinical trial 2025-520626-37-00: A Phase I/II Open-label, Dose Escalation and Dose Expansion Study to Evaluate the Safety, Pharmacokinetics, Pharmacodynamics, and Efficacy of AZD6621, a T Cell-engaging Antibody That Targets STEAP2, CD3, and CD8 in Adult Participants With Metastatic Prostate Cancer (ACTIVATED-4-PC)
Protocol code: D8020C00003
Sponsor: AstraZeneca AB (Pharmaceutical company). Phase: Phase I and Phase II (Integrated)- First administration to humans. Countries: Belgium (authorised, recruitment pending), Spain (authorised, recruiting), Poland (authorised, recruitment pending), Italy (authorised, recruitment pending), Netherlands (authorised, recruitment pending).
Therapeutic area(s): Diseases [C] - Neoplasms [C04]
Gender: Male. Age: 18-64 years, 65+ years. Enrolment: 45.
Start date (EU): 2026-07-29. Decision date: 2026-06-16. Results received: No. Last updated: 2026-06-17.
Decision dates by country: BE: 2026-06-16, IT: 2026-06-17, ES: 2026-06-17, NL: 2026-06-17, PL: 2026-06-16

Condition(s): Metastatic Prostate Cancer
Product: AZD6621

Primary endpoint: Incidence of adverse events (AEs), adverse events of special interest (AESIs), dose limiting toxicities (DLTs) (Part A only), and Serious Adverse events (SAEs)., Rate of AZD6621 discontinuation due to toxicity., Changes from baseline in laboratory parameters, vital signs, ECGs, and physical examination., Dose expansion (optimization Part B) only: PSA response rate.
Endpoint(s): PSA related: PSA response rate (Part A only), time to PSA response, duration of PSA response, durable PSA response rate, time to PSA progression., Radiological response assessed by the Investigator evaluated according to RECIST v1.1 (soft tissue) and PCWG3 (bone) criteria: overall response rate (ORR), duration of response (DoR), disease control rate (DCR), time to response (TTR), radiographic progression free survival (rPFS), durable response rate (DRR)., Percentage change in target lesion size using RECIST v1.1, OS, mOS., Time to first symptomatic skeletal-related events (SSRE)., Serum concentrations of AZD6621., Serum PK parameters of AZD6621, including but not limited to Cmax, Tmax, AUC, CL, and t1/2., The number and percentage of participants who develop anti-drug antibodies (ADAs) measured in serum.

Source: https://euclinicaltrials.eu/ctis-public/view/2025-520626-37-00